EU clinical trial 2022-501799-24-00: A 12-Month Randomized, Multicenter, Double-Blind, Placebo-Controlled Phase 3 Study to Evaluate the Safety and Efficacy of Daily Subcutaneous Metreleptin Treatment in Subjects with Partial Lipodystrophy
Protocol code: APG-20
Sponsor: Chiesi Farmaceutici S.p.A. (Pharmaceutical company). Phase: Therapeutic confirmatory (Phase III). Countries: Spain (ended), Netherlands (ended), Belgium (ended), Poland (ongoing, recruitment ended).
Therapeutic area(s): Phenomena and Processes [G] - Metabolism [G03]
Gender: Female, Male. Age: 0-17 years, 18-64 years, 65+ years. Enrolment: 16.
Start date (EU): 2024-03-07. Decision date: 2023-02-02. Results received: No. Last updated: 2026-06-03.
Decision dates by country: NL: 2023-02-02, PL: 2023-02-07, BE: 2023-02-03, ES: 2023-02-06

Condition(s): partial lipodystrophy
Product: Metreleptin for injection (placebo), Myalepta 11.3 mg powder for solution for injection

Primary endpoint: Change from Baseline to Month 6 in glycated hemoglobin (HbA1c) in subjects with FPLD in Groups A and C (HbA1c ≥7%), Percent change from Baseline to Month 6 in fasting triglycerides (TGs) in subjects with FPLD in Groups B and C (TG ≥500 mg/dL [5.65 mmol/L])
Endpoint(s): Change from Baseline to Month 6 in FBG in Groups A and C (HbA1c ≥7%), Change from Baseline to Month 6 in FBG in subjects with FBG above upper limit of normal (ULN)

Source: https://euclinicaltrials.eu/ctis-public/view/2022-501799-24-00